EU clinical trial 2023-503845-79-01: The induction of respiratory immune responses by epicutaneous vaccination with the MMR vaccine
Protocol code: LGS.MMR.02.2022.2025
Sponsor: Rigshospitalet (Hospital/Clinic/Other health care facility). Phase: Therapeutic exploratory (Phase II). Countries: Denmark (ended).
Therapeutic area(s): Phenomena and Processes [G] - Immune System Phenomena [G13]; Diseases [C] - Virus Diseases [C02]
Gender: Female, Male. Age: 18-64 years. Enrolment: 40.
Status: Ended. Start date (EU): 2024-11-24. End date (EU): 2025-09-30. Decision date: 2023-06-20. Results received: No. Last updated: 2025-11-18.

Condition(s): Measles, mumps, and rubella
Product: M-M-RvaxPro powder and solvent for suspension for injection Measles, mumps and rubella vaccine (live), M-M-RvaxPro powder and solvent for suspension for injection Measles, mumps and rubella vaccine (live)

Primary endpoint: Primary endpoint The primary trial endpoint is levels of measles-specific mucosal IgA immune response 3 months after EV compared with the standard MMRvaccine administration by subcutaneous/intramuscular injection as measured by ELISA methods. We hypothesize that there is no significant difference between the levels.
Endpoint(s): Nasal secretion and serum: Measles neutralizing antibodies measured by gold standard PRNT Measles, mumps, and rubella IgG, IgM and IgA measured by ELISA Full blood: Measles-specific CD4+ and CD8+ T-cell responses Tonsil brushings: Measles-specific CD4+ and CD8+ T-cell responses Side effects: Frequency of side effects/adverse events 30 days after vaccination will be compared

Source: https://euclinicaltrials.eu/ctis-public/view/2023-503845-79-01